EU clinical trial 2024-518796-65-00: Single-center phase II study on the use of electrochemotherapy in the treatment of Paget's disease and high-grade or initially invasive precancerous squamous lesions of the vulva (GinOnc-ECT study)
Protocol code: GinOnc-ECT
Sponsor: Fondazione Policlinico Universitario Agostino Gemelli IRCCS (Hospital/Clinic/Other health care facility). Phase: Therapeutic exploratory (Phase II). Countries: Italy (ended).
Therapeutic area(s): Diseases [C] - Neoplasms [C04]
Gender: Female. Age: 18-64 years, 65+ years. Enrolment: 18.
Status: Ended. Start date (EU): 2023-06-17. End date (EU): 2026-05-31. Decision date: 2024-11-25. Results received: No. Last updated: 2024-11-25.

Condition(s): patients with newly diagnosed or recurrent high-grade or initially invasive precancerous squamous lesions of the vulva and non-invasive vulvar Paget's disease
Product: BLEOMYCIN, CISPLATIN

Primary endpoint: Evaluation of histological pathological response of vulvar lesions and non-invasive Paget's disease on surgical specimens 30 days after electrochemotherapy according to RECIST criteria
Endpoint(s): Safety of the method evaluated using the CTCAE criteria v. 5.0, Assessment of HPV persistence by HPV test at the 6-month visit, Duration of disease control in follow-up, Symptomatology assessment using specific questionnaires (VAS, EQ-5D, FSFI) filled in by patients before treatment and one, three, six and twelve months after treatment

Source: https://euclinicaltrials.eu/ctis-public/view/2024-518796-65-00